EU clinical trial 2024-514393-44-00: Cannabidiol as an Add-on Treatment to substance abuse in juvenile patients with PSYchosis: a double-blind randomized placebo-controlled study.
Protocol code: CAT-PSY
Sponsor: Fondazione IRCCS Ca Granda Ospedale Maggiore Policlinico (Hospital/Clinic/Other health care facility). Phase: Therapeutic exploratory (Phase II). Countries: Italy (ended).
Therapeutic area(s): Psychiatry and Psychology [F] - Behavioral Disciplines and Activities [F04]; Psychiatry and Psychology [F] - Behavior and Behavior Mechanisms [F01]; Psychiatry and Psychology [F] - Mental Disorders [F03]
Gender: Female, Male. Age: 0-17 years, 18-64 years. Enrolment: 60.
Status: Ended. End date (EU): 2025-10-06. Decision date: 2024-09-17. Results received: No. Last updated: 2024-09-17.

Condition(s): Substance-Induced Psychosis
Product: CBD, ABILIFY 1 mg/ml oral solution, Aripiprazolo Aurobindo 15 mg compresse, ARIPIPRAZOLE, Composition (%w/V): Sesame oil, refined 90,00, Ethanol, anhydrous 7,91, Sucralose 0,05, DL-alfa-tocopheryl acetate 0,18, Raspberry flavor 0,02.

Primary endpoint: As primary endpoint, we expect a greater reduction of cannabis use relapse symptoms in the CBD-group compared to the placebo-group. Specifically, we expect a greater mean change on the ASI scores from baseline to follow-up (6 months) in the CBD group compared to the placebo group.
Endpoint(s): We expect better scores, and therefore a reduction in clinical symptomatology and a better performance in cognitive tests, in the CBD-group compared to placebo-group in all the clinical and cognitive scales employed. Specifically, we expect a greater mean change on the above-mentioned scales scores from baseline to follow-up (6 months) in the CBD group compared to the placebo group., Moreover, we expect to identify a more favorable brain connectivity and neuroplasticity profile the CBD-group vs placebo-group. Specifically, we expect a greater normalization of brain structural and functional alterations from baseline to follow-up (6 months) in the CBD group compared to the placebo group.

Source: https://euclinicaltrials.eu/ctis-public/view/2024-514393-44-00